EU clinical trial 2023-508398-10-00: Discontinuation of rituximab compared with rituximab maintenance in ANCA-associated vasculitis – a randomized non-blinded controlled trial (DISRITUX)
Sponsor: Region Oestergoetland (Hospital/Clinic/Other health care facility). Phase: Therapeutic use (Phase IV). Countries: Sweden (ongoing, recruiting), Denmark (authorised, recruitment pending), Ireland (authorised, recruitment pending), Austria (authorised, recruitment pending), Iceland (authorised, recruitment pending), Netherlands (authorised, recruitment pending), Germany (authorised, recruitment pending).
Therapeutic area(s): Diseases [C] - Immune System Diseases [C20]; Diseases [C] - Musculoskeletal Diseases [C05]
Gender: Female, Male. Age: 18-64 years, 65+ years. Enrolment: 130.
Start date (EU): 2024-12-12. Decision date: 2024-06-20. Results received: No. Last updated: 2026-07-08.
Decision dates by country: AT: 2026-06-17, DK: 2026-06-12, DE: 2026-06-19, IS: 2026-06-22, IE: 2026-06-12, NL: 2026-06-17, SE: 2024-06-20

Condition(s): ANCA-associated vasculitis
Product: RITUXIMAB

Primary endpoint: Disease relapse rate, from randomization to relapse
Endpoint(s): Time to relapse (either minor or major), Proportion of patients who maintain AAV remission at 24 and 36 months., Serological response during study (ANCA positivity vs negativity), Loss of kidney function (eGFR slope from randomization+ fixed points at 12, 24, and 36 months), Start of kidney replacement therapy, Duration (number of months) and doses of RTX treatment prior to randomization, Duration (number of months) of GC exposure prior to randomization, Cumulative GC exposure from randomization to end of study end of study or relapse whichever comes first, Cumulative accrual of damage measured by the Vasculitis Damage Index (VDI) scale, Health-related quality of life measurements, Serious adverse event rate, Frequency of AEs of special interest (AESI), Health economics

Source: https://euclinicaltrials.eu/ctis-public/view/2023-508398-10-00